EU clinical trial 2023-509210-10-00: Treatment of cancer with Immune Checkpoint Inhibition therapy boosted by High Intensity Focused Ultrasound Histotripsy (the iFOCUS study)
Protocol code: NL85300.041.23
Sponsor: Universitair Medisch Centrum Utrecht (Hospital/Clinic/Other health care facility). Phase: Human Pharmacology (Phase I)- Other. Countries: Netherlands (ongoing, recruiting).
Therapeutic area(s): Diseases [C] - Neoplasms [C04]
Gender: Female, Male. Age: 18-64 years, 65+ years. Enrolment: 24.
Status: Ongoing, recruiting. Start date (EU): 2024-07-26. Decision date: 2024-02-29. Results received: No. Last updated: 2025-11-06.

Condition(s): Metastatic or unresectable solid malignancies. Standard of care treatment options must not be available or not be considered feasible. Patients must have a primary tumor or metastasis that is suitable for HIFU-HT treatment.

Source: https://euclinicaltrials.eu/ctis-public/view/2023-509210-10-00